EU clinical trial 2024-518244-20-01: DISCUS: A Randomised Phase II Study Comparing 3 vs 6 Cycles of Platinum-based Chemotherapy Prior to Maintenance Avelumab in Advanced Urothelial Cancer
Protocol code: DISCUS
Sponsor: Queen Mary University Of London (Educational Institution). Phase: Therapeutic exploratory (Phase II). Countries: Spain (ongoing, recruitment ended), France (ongoing, recruitment ended).
Therapeutic area(s): Diseases [C] - Neoplasms [C04]
Gender: Female, Male. Age: 18-64 years, 65+ years. Enrolment: 193.
Status: Ongoing, recruitment ended. Start date (EU): 2022-04-25. Decision date: 2024-11-26. Results received: No. Last updated: 2026-06-12.
Decision dates by country: FR: 2024-11-28, ES: 2024-11-26

Condition(s): Urothelial Carcinoma
Product: Bavencio 20 mg/mL concentrate for solution for infusion

Primary endpoint: Change in GHS/QoL scale scores from baseline to completion of 6 cycles of treatment. Patients who withdraw from treatment between Cycles 4 and 6 will be included, provided an EORTC QLQ-C30 questionnaire is completed within 14 days from the date of withdrawal.
Endpoint(s): • Quality of Life assessment from baseline to the completion of 10 Cycles of treatment using the GHS/QOL scale score, as per the primary endpoint methodology., • Quality of Life assessment from the beginning of cycle 5 to the completion of 10 Cycles of treatment using the GHS/QOL scale score, as per the primary endpoint methodology., • Change in GHS/QOL scale scores from baseline to the end of assessment (wk54), as per the primary endpoint methodology., • GHS/QoL scale score time to deterioration (TTD), where deterioration in the GHS/QoL scale score is defined as a decrease by ≥10 points at any time point after baseline with no subsequent observations with a <10 point decrease from baseline., • Change in the GHS/QOL scale score from baseline as per the primary endpoint, but adjusted for baseline imbalances in GHS/QOL scale scores., Performance status as measured by the Karnofsky Scale on completion of 6 cycles of treatment., • Incidence, nature and severity of adverse events graded according to NCI-CTCAE v5.0 at the following timepoints: o Throughout treatment o On completion of Cycle 6 of treatment o Between Cycle 4 and the completion of Cycle 10. • Treatment discontinuation rate due to AEs., Overall response rate in each randomised treatment arm defined as the proportion of patients who achieved complete response (CR) or partial response (PR) according to RECIST v1.1 recorded from randomisation until week 20. (investigator assessed unconfirmed best response), Progression free survival rate at 20 weeks post randomisation (PFS rate) in each treatment arm defined as the proportion of patients who did not experience disease progression or death from any cause according to RECIST v1.1 recorded from randomisation until week 20., Duration of response defined as the time from first documentation of CR or PR to disease progression (RECIST v1.1) or death from any cause, whichever occurs first., Overall survival (OS), defined as the time between the date of randomisation and death due to any cause.

Source: https://euclinicaltrials.eu/ctis-public/view/2024-518244-20-01